EU clinical trial 2024-513424-42-01: The Pragmatic EE-PRS Trial assessing Polygenic Risk Driven Statin Therapy for Cardiovascular Disease Prevention
Protocol code: EEPRS12308
Sponsor: University Of Tartu (Educational Institution). Phase: Therapeutic use (Phase IV). Countries: Estonia (ongoing, recruitment ended).
Therapeutic area(s): Diseases [C] - Cardiovascular Diseases [C14]
Gender: Female, Male. Age: 18-64 years, 65+ years. Enrolment: 2500.
Status: Ongoing, recruitment ended. Start date (EU): 2025-03-25. Decision date: 2024-12-19. Results received: No. Last updated: 2026-05-13.

Condition(s): High polygenic risk for coronary artery disease
Product: ATORVASTATIN, ROSUVASTATIN, ROSUVASTATIN

Primary endpoint: Time to the first occurrence of Major Adverse Cardiovascular Events (MACE), ICD-10 codes: ischaemic heart disease (I20–I25), stroke or transient ischemia (I60–64, I69, G45), peripheral vascular occlusion (I65–66, I67.2, I70, I73.9), revascularization (Z95.1, Z95.5, Z95.8, Z95.9) or cardiovascular death (I00-78) from baseline.
Endpoint(s): - Incidence rate of death from any cause among the study participants., - Change in CVD risk factors from baseline (LDL-cholesterol, blood pressure, BMI, waist circumference, smoking, alcohol consumption prevalence) by the end of the trial in the intervention and control arm., - Treatment adherence in the intervention arm based on prescriptions and purchases of statins (C10AA, C10BA) and self-reporting using the MARS-5 scale., - Fidelity of implementation assessed by participant feedback, and adherence to program activities (record analysis)., - Acceptability of the primary prevention program across study participants., - Satisfaction with study processes and results., Difference in plasma concentrations of rosuvastatin comparing study participants with and without a mutation in the SLCO1B1, ABCG2, CYP2C9, CYP2C19, UGT-d, SLCO1B3, SLCO2B1, ABCC2, ABCB11 genes., Difference in rosuvastatin side effects between study participants with and without a mutation in the SLCO1B1, ABCG2, CYP2C9, CYP2C19, UGT-d, SLCO1B3, SLCO2B1, ABCC2, ABCB11 genes., Difference in side effects and overall trial outcomes depending on gut microbiome composition and functionality., Utilisation of healthcare resources (non-trial physician and cardiologist visits, hospitalizations, length of stay, health care and informal resource use, direct healthcare costs.), - Number of participants with adverse events and serious adverse events from statin therapy., - Number of participants who withdrew or dropped out from the study., - Utilities from the EQ-5L-5D surveys and productivity costs from the iPCQ survey for calculating quality-adjusted life years (QALY) gained over a lifetime, incremental cost-effectiveness ratio (ICER).

Source: https://euclinicaltrials.eu/ctis-public/view/2024-513424-42-01